EU clinical trial 2022-501594-39-00: Pharmacokinetics of anti-lymphocyte serum in the prevention of GvHD in children and adults receiving allogeneic hematopoietic stem cell transplantation - PHASAL-GA Study
Protocol code: 69HCL21_1186
Sponsor: Hospices Civils De Lyon (Hospital/Clinic/Other health care facility). Phase: Therapeutic use (Phase IV). Countries: France (ended).
Therapeutic area(s): Diseases [C] - Hemic and Lymphatic Diseases [C15]
Gender: Female, Male. Age: 0-17 years, 18-64 years, 65+ years. Enrolment: 35.
Status: Ended. Start date (EU): 2023-07-17. End date (EU): 2025-11-26. Decision date: 2023-04-13. Results received: No. Last updated: 2025-09-05.

Condition(s): pediatric and adult patients undergoing HSC allograft procedures with Thymoglobulin® packaging
Product: THYMOGLOBULINE 5 mg/ml, poudre pour solution pour perfusion

Primary endpoint: Measurement of plasma SAL exposure (mean AUC and standard deviation in the study population), calculated using population PK methodology
Endpoint(s): objective function value (OFV), Coefficient of variation of the AUC

Source: https://euclinicaltrials.eu/ctis-public/view/2022-501594-39-00